EU clinical trial 2023-509499-41-00: TARSARC : TARGETING ATR IN SOFT-TISSUE SARCOMAS: A RANDOMIZED PHASE II STUDY
Protocol code: IB 2018-04
Sponsor: Institut Bergonie (Hospital/Clinic/Other health care facility). Phase: Therapeutic exploratory (Phase II). Countries: France (ended).
Therapeutic area(s): Diseases [C] - Neoplasms [C04]
Gender: Female, Male. Age: 18-64 years, 65+ years. Enrolment: 72.
Status: Ended. Start date (EU): 2022-02-03. End date (EU): 2026-04-21. Decision date: 2024-03-12. Results received: No. Last updated: 2024-11-28.

Condition(s): Adult patients with locally advanced/unresectable and/or metastatic soft-tissue leiomyosarcomas.
Product: GEMCITABINE ARROW 40 mg/ml, solution à diluer pour perfusion, Berzosertib (M6620)

Primary endpoint: Efficacy of berzosertib in association with gemcitabine (Arm A) as well of efficacy of gemcitabine alone (Arm B) will be assessed, independently for each arm, in terms of 6-month progression-free rate (PFR). PFR is defined as the rate of complete or partial response (CR, PR) or stable disease (SD), as per RECIST v1.1. This endpoint is a validated endpoint in STS. Radiological centralized review data will be used for the primary endpoint analysis.
Endpoint(s): 1. Antitumor activity of the association will be assessed as well in terms of:, a) Objective response defined as complete response (CR) or partial response (PR) as per adapted RECIST v1.1. The objective response rate (ORR) at 6 months will be reported independently for each arm., b) Best overall response defined as the best response across all time points (RECIST v1.1). Best overall response rate will be reported independently for each arm., c) Progression-free survival (PFS) defined as the delay between the start date of treatment and the date of progression (as per RECIST v1.1) or death (from any cause), whichever occurs first. Median PFS, 1- and 2-year PFS rates will be reported independently for each arm., d) Overall survival (OS) defined as the delay between the start date of treatment and the date of death (of any cause). Median OS, 1- and 2-year OS rates will be reported independently for each arm., e) SM-1 (MSA3) suppression, f) Safety profile of berzosertib in association with gemcitabine. Events will be graded using the Common Terminology Criteria for Adverse Events (CTCAE) from the NCI v5.0. Both AE and SAE will be coded according to the standardized medical terminology MedDRA., 2. Biomarker study: To perform pharmacodynamic (PD)/mechanism of action(MOA) biomarkers analysis as well as predictive biomarkers analysis, in blood and tumor tissue sample at different time points. This may include butnot limited to the following: analysis of fixed PBMCs using immunofluorescence and confocal microscopy inorder of priority: pSer296 Chk1, total Chk1, gammaH2AX, RAD51, pS317 Chk1 and pS345 Chk1, immune profiling, markers of genetic instability including microsatellite instability), 3. Exploratory analyses of ctDNA for mutations relating to resistance to ATR inhibitor therapy in blood samples collected at baseline.

Source: https://euclinicaltrials.eu/ctis-public/view/2023-509499-41-00